EU clinical trial 2023-507715-35-02: MEDICAL CANNABIS FOR NEURODEGENERATIVE DISEASES: A RANDOMIZED, DOUBLE-BLIND, PLACEBO-CONTROLLED PHASE II CLINICAL TRIAL (NEUROBIS)
Protocol code: NEUROBIS
Sponsor: Azienda Ospedaliero-Universitaria Maggiore Della Carita (Hospital/Clinic/Other health care facility). Phase: Therapeutic exploratory (Phase II). Countries: Italy (ongoing, recruiting).
Therapeutic area(s): Diseases [C] - Nervous System Diseases [C10]
Gender: Female, Male. Age: 18-64 years, 65+ years. Enrolment: 186.
Status: Ongoing, recruiting. Start date (EU): 2024-09-30. Decision date: 2024-07-17. Results received: No. Last updated: 2024-07-17.

Condition(s): Patients suffering from neurodegenerative diseases: Amyotrophic Lateral Sclerosis (ALS), Alzheimer’s Disease (AD) and Parkinson’s Disease (PD).
Product: Mixture of Sesame oil / Linseed oil (9:1), Cannabis Extract Avextra 10/10 Solution

Primary endpoint: To demonstrate for the total study population (all 3 neurodegenerative diseases) superiority with regards to improving Quality of Life, assessed with the Short Form 36 Health Survey (SF-36), compared to placebo., To assess for the total study population the safety and tolerability, incidence of treatment-emergent adverse events (TAEDs) and discontinuation rate of cannabis extract Avextra 10/10 compared to placebo.
Endpoint(s): To demonstrate for the total study population (all 3 neurodegenerative diseases) superiority with regards to improving caregiver distress as assessed by a structured interview by an expert neuropsychologist using the Zarit Burden Interview (22-items) and the Caregiving Distress Scale., To demonstrate for the total study population (all 3 neurodegenerative diseases) superiority with regards to improving a patient-reported outcome measure evaluated through the Patient Global Impression of Change (PGIC) compared to placebo., To demonstrate in the subpopulation of patients with Alzheimer’s disease (AD) superiority with regards to improvements on specific clinical disease marker functional disability using the standardized Mini Mental Status Examination (MMSE) to evaluate the cognitive functions and the Neuropsychiatric Inventory-agitation subscale for agitation in AD., To demonstrate in the subpopulation of patients with Amyotrophic Lateral Sclerosis superiority with regards to improvements on specific clinical disease marker functional disability using the ALS functional rating scale - revised (ALSFRS-R) score for functional status in ALS., To demonstrate in the subpopulation of patients with Parkinson’s disease superiority with regards to improvements on specific clinical disease marker functional disability using the unified Parkinson's disease rating scale (UPDRS) for monitoring the longitudinal course of PD.

Source: https://euclinicaltrials.eu/ctis-public/view/2023-507715-35-02